EU clinical trial 2024-512997-89-00: A Phase 1 /2 study for the safety, efficacy, pharmacokinetic and pharmacodynamics evaluation of amcenestrant (SAR439859 ), administered orally as monotherapy, then in combination with other anti-cancer therapies in postmenopausal women with estrogen receptor-positive advanced breast cancer
Protocol code: TED14856
Sponsor: Sanofi-Aventis Recherche & Developpement (Pharmaceutical company). Phase: Phase I and Phase II (Integrated)- First administration to humans. Countries: Belgium (ended), Spain (ended).
Therapeutic area(s): Diseases [C] - Neoplasms [C04]
Gender: Female. Age: 18-64 years, 65+ years. Enrolment: 3.
Status: Ended. Start date (EU): 2019-01-29. End date (EU): 2024-11-08. Decision date: 2024-10-23. Results received: Yes. Last updated: 2024-10-23.
Decision dates by country: BE: 2024-10-23, ES: 2024-10-23

Condition(s): Cancer
Product: SAR439859, Verzenios 100 mg film-coated tablets, IBRANCE 125 mg hard capsules, Verzenios 150 mg film-coated tablets, IBRANCE 75 mg hard capsules, Verzenios 50 mg film-coated tablets, IBRANCE 100 mg hard capsules

Primary endpoint: Dose Limiting Toxicities (DLTs), Objective Response Rate (ORR), Adverse Events
Endpoint(s): Adverse Events, ORR, Time to First Response (TTR), Clinical Benefit Rate (CBR), Duration of response, Tlag of amcenestrant after single dose, Tmax of amcenestrant after single dose, Cmax of amcenestrant after single dose, AUC0-24 of amcenestrant after single dose, Tmax of amcenestrant after repeated dose administration, Cmax of amcenestrant after repeated dose administration, AUC0-24 of amcenestrant after repeated dose administration, Ctrough of amcenestrant during repeated dose administration, Tmax of palbociclib after single dose, Cmax of palbociclib after single dose, AUC0-24 of palbociclib after single dose, Tmax of palbociclib after repeated dose administration, Cmax of palbociclib after repeated dose administration, AUC0-24 of palbociclib after repeated dose administration, Urine excretion of amcenestrant, Cholesterol concentration ratios, ER occupancy at 18F-FES-PET imaging, Progression free survival, Observation of tumor changes by FES PET and FDG PET scans, Tmax of alpelisib after third dose, Cmax of alpelisib after third dose, AUC0-24 of alpelisib after third dose, Tmax of alpelisib after repeated dose administration, Cmax of alpelisib after repeated dose administration, AUC0-24 of alpelisib after repeated dose administration, Tmax of everolimus after single dose, Cmax of everolimus after first dose, AUC0-24 of everolimus after single dose, Tmax of everolimus after repeated dose administration, Cmax of everolimus after repeated dose administration, AUC0-24 of everolimus after repeated dose administration, Tmax of abemaciclib after single dose, Cmax of abemaciclib after single dose, AUC0-24 of abemaciclib after single dose, Tmax of abemaciclib after repeated dose administration, Cmax of abemaciclib after repeated dose administration, AUC0-24 of abemaciclib after repeated dose administration

Source: https://euclinicaltrials.eu/ctis-public/view/2024-512997-89-00